EU clinical trial 2024-512710-17-00: Study of RP3 Monotherapy and RP3 in Combination With Nivolumab in Patients With Solid Tumors
Protocol code: RP3-301
Sponsor: Replimune Group Inc. (Pharmaceutical company). Phase: Human Pharmacology (Phase I)- First administration to humans. Countries: Spain (ended), France (ended), Greece (ended).
Therapeutic area(s): Diseases [C] - Neoplasms [C04]
Gender: Female, Male. Age: 18-64 years, 65+ years. Enrolment: 36.
Status: Ended. Start date (EU): 2022-11-22. End date (EU): 2026-03-20. End date: 2026-05-15. Decision date: 2024-12-02. Results received: No. Last updated: 2026-02-23.
Decision dates by country: ES: 2024-12-02, FR: 2024-12-06, GR: 2024-12-09

Condition(s): Advanced solid tumors

Source: https://euclinicaltrials.eu/ctis-public/view/2024-512710-17-00